EU clinical trial 2024-519166-48-01: Efficacy and safety of circumcision alone on risk of febrile urinary tract infections in boys with posterior urethral valves: a prospective randomized open-label multicentric trial enriched with historic controls. CIRCUP 2
Protocol code: CHUBX 2023/52
Sponsor: Centre Hospitalier Universitaire De Bordeaux (Hospital/Clinic/Other health care facility). Phase: Therapeutic exploratory (Phase II). Countries: France (ongoing, recruiting).
Therapeutic area(s): Diseases [C] - Male Urogenital Diseases [C12]
Gender: Male. Age: 0-17 years. Enrolment: 163.
Status: Ongoing, recruiting. Start date (EU): 2026-07-02. Decision date: 2025-06-06. Results received: No. Last updated: 2025-08-18.

Condition(s): Posterior Urethral Valves
Product: Bactrim 40 mg/ml + 8 mg/ml mikstur, suspensjon, ALFATIL 125 mg/5 ml poudre pour suspension buvable, AUGMENTIN 100 mg/12,50 mg par ml NOURRISSONS, poudre pour suspension buvable en flacon (rapport amoxicilline/acide clavulanique : 8/1)

Primary endpoint: Time to first fUTI between baseline and 2 years. The diagnosis of fUTI is defined as fever (>38.5° Celsius) with evidence of pyuria and culture-proven infection on urinalysis, obtained by urethral catheterization or suprapubic aspiration, as well as biological signs of inflammation.
Endpoint(s): Median number of fUTIs at 2 years in children with at least 1 fUTI during follow-up, The proportion of children with worsening renal scans (defined as an increase in heterogeneity and number of cortical defects) between baseline and 2-years between children with and without fUTIs, The types of germs responsible for fUTIs, Baseline risk factors for fUTIs from regression models (exploratory), Exploratory sub-group analyses in children with and without urinary reflux at baseline, Adherence to antibiotic prophylaxis in the control group, Absolute risk difference of first fUTI with circumcision alone versus circumcision and antibiotic prophylaxis;and antibiotic prophylaxis alone respectively.

Source: https://euclinicaltrials.eu/ctis-public/view/2024-519166-48-01